EU clinical trial 2025-521713-57-00: A Phase 1/2a Study of REGN7041 (anti-CD3 monoclonal antibody) in patients with Active Noninfectious Uveitis affecting the Posterior Segment
Protocol code: R7041-NIU-24123
Sponsor: Regeneron Pharmaceuticals Inc. (Pharmaceutical company). Phase: Phase I and Phase II (Integrated)- First administration to humans. Countries: France (ended).
Therapeutic area(s): Diseases [C] - Eye Diseases [C11]
Gender: Female, Male. Age: 18-64 years, 65+ years. Enrolment: 5.
Status: Ended. End date (EU): 2026-07-30. Decision date: 2026-03-05. Results received: No. Last updated: 2026-04-01.

Condition(s): Noninfectious Uveitis
Product: REGN7041

Primary endpoint: Occurrence of Treatment-Emergent Adverse Events (TEAEs)
Endpoint(s): Concentrations of REGN7041 in serum, Incidence of Anti-Drug Antibodies (ADAs) to REGN7041 in serum, Magnitude of ADAs to REGN7041 in serum

Source: https://euclinicaltrials.eu/ctis-public/view/2025-521713-57-00